EU clinical trial 2024-520086-31-00: HYDrochlorothiazidE compared to valsartan to treat arterial hypertension in patients with Hypertrophic obstructive CardioMyopathy – the multicenter, randomized, double-blind, controlled, crossover HYDE-HCM Trial
Protocol code: NV-2025-01
Sponsor: Medical University Of Graz (Educational Institution). Phase: Therapeutic use (Phase IV). Countries: Austria (ongoing, recruiting).
Therapeutic area(s): Diseases [C] - Cardiovascular Diseases [C14]
Gender: Female, Male. Age: 18-64 years, 65+ years. Enrolment: 40.
Status: Ongoing, recruiting. Start date (EU): 2026-01-07. Decision date: 2025-12-29. Results received: No. Last updated: 2025-12-29.

Condition(s): Hypertrophic cardiomyopathy
Product: HCT G.L. 50 mg-Tabletten, Valsartan Sandoz 160 mg - Filmtabletten

Primary endpoint: Difference in absolute change of peak LVOT gradient at rest from before to after the treatment period between the two interventions
Endpoint(s): Difference of absolute changes between the two intervention groups of Peak LVOT gradient after Valsalva-Maneuver, Difference of absolute changes between the two intervention groups of left ventricular systolic pressure calculated from brachial blood pressure and LVOT gradient, Difference of absolute changes between the two intervention groups of Kansas City Cardiomyopathy Questionnaire (KCCQ-23 Score), Difference of absolute changes between the two intervention groups of EQ5D5L score, Difference of absolute changes between the two intervention groups of NT-proBNP, Difference of absolute changes between the two intervention groups of High-sensitive Troponin T/I, Difference of absolute changes between the two intervention groups of Interleukin-6, Difference of absolute changes between the two intervention groups of pVO2 during CPET (CPET sub-study), Difference of absolute changes between the two intervention groups of mean systolic postprandial office blood pressure, Difference of absolute changes between the two intervention groups of mean diastolic postprandial office blood pressure, Number of serious adverse events (SAEs), Difference of absolute changes between the two intervention groups of NYHA class

Source: https://euclinicaltrials.eu/ctis-public/view/2024-520086-31-00